EU clinical trial 2024-516647-79-00: Pain medication tapering for chronic low back pain patients, treated with an intervention focusing on pain relief for axial problems.
Sponsor: Vrije Universiteit Brussel (Educational Institution). Phase: Phase III and phase IV (Integrated). Countries: Belgium (ongoing, recruiting).
Therapeutic area(s): Diseases [C] - Musculoskeletal Diseases [C05]
Gender: Female, Male. Age: 18-64 years, 65+ years. Enrolment: 195.
Status: Ongoing, recruiting. Start date (EU): 2023-06-28. Decision date: 2024-10-18. Results received: No. Last updated: 2026-03-02.

Condition(s): Persistent Spinal Pain Syndrome Type II (PSPS T2)
Product: Catapressan 150 microgrammes comprimés, Suboxone 8 mg/2 mg sublingual tablets, OxyNorm Instant 20 mg, comprimés orodispersibles, Libroxar 8 mg / 2 mg comprimés sublinguaux, OxyNorm Instant 10 mg, comprimés orodispersibles, Libroxar 2 mg/0.5 mg Sublingualtabletten, Catapressan 150 microgrammes /1 ml solution injectable/solution pour perfusion, OxyNorm Instant 5 mg, comprimés orodispersibles, Suboxone 2 mg/0.5 mg sublingual tablets

Primary endpoint: The primary endpoint is to observe whether there is a difference in the ODI score in patients with chronic lower back pain 12 months after an intervention focusing on pain relief for axial problems between the three arms. A longitudinal mixed model analysis will be used with timepoints defined at baseline, 1 month, 3 months, 6 months, and 12 months after the intervention.

Source: https://euclinicaltrials.eu/ctis-public/view/2024-516647-79-00